EU clinical trial 2024-513314-35-00: Neoadjuvant immune checkpoint inhibition and novel IO combinations in early-stage colon cancer - the NICHE trial
Protocol code: N16NCI
Sponsor: Het Nederlands Kanker Instituut-Antoni van Leeuwenhoek Ziekenhuis Stichting (Hospital/Clinic/Other health care facility). Phase: Therapeutic exploratory (Phase II). Countries: Netherlands (ongoing, recruiting).
Therapeutic area(s): Diseases [C] - Neoplasms [C04]
Gender: Female, Male. Age: 18-64 years, 65+ years. Enrolment: 353.
Status: Ongoing, recruiting. Start date (EU): 2017-01-20. Decision date: 2024-11-12. Results received: No. Last updated: 2026-06-26.

Condition(s): Adenocarcinoma of the Colon or rectosigmoid (considered as non-rectal)
Product: anti-IL8 mAb, Relatlimab intravenous, YERVOY 5 mg/ml concentrate for solution for infusion, Celebrex 200 mg harde capsules, OPDIVO 10 mg/mL concentrate for solution for infusion.

Primary endpoint: Efficacy as measured by major pathologic response rate (≤10% residual viable tumor (RVT))
Endpoint(s): To assess the major pathological response rate (MPR, <10% viable tumor rest) and complete response rate and whether response correlates with DFS, To find biomarkers and evaluation strategies able to accurately assess complete and nearcomplete responses in order to pursue organ-sparing treatment (omission of surgery) in this patient population in future trials, To expand current exploratory translational analyses, Analysis of immune cell infiltration and the difference with inflamed pMMR tumors pre- and post-treatment: why is there no pathological response in pMMR tumors showing immune activation? And are there any differences between complete and near-complete responders?, Primary readout will be the effect of therapy on intratumoral T-cell infiltration, CD4, CD8 infiltration and immune checkpoints upregulation (including but not limited to PDL1 and LAG3 assessment for nivo/rela cohorts) in the time interval pre- and post-treatment in biopsies, Immunogenic mutational load will be determined by tumor tissue DNA WES. Peripheral blood DNA WES will also be performed and used as a control for somatic mutation sorting (only genes relating to colon cancer and/or immune-related genes, deemed informational for this study, will be assessed), Immune suppressive pathways, IFN-y induced gene expression and COX2 induced gene expression changes will be analyzed by use of RNA sequencing on pre- and post-therapy tissue, Date of relapse, as determined by disease recurrence or disease-related death during follow-up after surgery. Follow-up will be performed according to local and/or national guidelines, Safety, evaluated by the incidence and severity of irAEs, SAEs and the frequency of delays of surgery >2 weeks from the intended date due to treatment related complications (if not a primary objective of the cohort), To evaluate health-related quality of life through patient reported outcome measures

Source: https://euclinicaltrials.eu/ctis-public/view/2024-513314-35-00